EU clinical trial 2024-518916-38-00: A multicenter, randomized, double-blind, placebo-controlled, proof of concept trial to investigate the efficacy and safety of intra-articular 4P004 in subjects with knee synovitis and osteoarthritis
Protocol code: 4MB-4P004-P-INFLAM
Sponsor: 4moving Biotech (Pharmaceutical company). Phase: Therapeutic exploratory (Phase II). Countries: Denmark (ongoing, recruitment ended), France (ongoing, recruitment ended), Poland (ongoing, recruitment ended), Spain (ongoing, recruitment ended).
Therapeutic area(s): Diseases [C] - Musculoskeletal Diseases [C05]
Gender: Female, Male. Age: 18-64 years, 65+ years. Enrolment: 84.
Status: Ongoing, recruitment ended. Start date (EU): 2025-09-29. Decision date: 2025-08-06. Results received: No. Last updated: 2026-08-06.
Decision dates by country: ES: 2025-08-14, PL: 2025-08-18, FR: 2025-08-06, DK: 2025-08-07

Condition(s): knee synovitis and osteoarthritis
Product: 0.9% w/v Sodium Chloride Injection BP, 4P-004

Primary endpoint: Change from Baseline at W4 in the weekly average of TK daily pain intensity using the WOMAC Pain subscore
Endpoint(s): Change from Baseline at W2, W6, W8, W10 and W12: - Weekly average of TK daily pain (WOMAC Pain), Change from Baseline at W2, W4, W8 and W12: - NRS (0-10) pain in a nominated pain aggravating activity - WOMAC subscores and total score - Patient Global Assessment of OA (PGA-OA), % of OMERACT-OARSI Responders at W2, W4, W8 and W12, Incidence and severity of TEAEs during the trial, Absolute values and changes from Baseline in: - Clinical laboratory assessments (hematology, chemistry, and urinalysis) - Vital signs (systolic and diastolic blood pressure [BP], pulse rate,), Directed physical examination

Source: https://euclinicaltrials.eu/ctis-public/view/2024-518916-38-00